EU clinical trial 2023-503793-20-00: (20604 OCEANIC STROKE) A multicenter, randomized, placebo controlled, double-blind, parallel group and event driven Phase 3 study of the oral FXIa inhibitor asundexian (BAY 2433334) for the prevention of ischemic stroke in male and female participants aged 18 years and older after an acute non-cardioembolic ischemic stroke or high-risk TIA
Protocol code: 20604
Sponsor: Bayer AG (Pharmaceutical company). Phase: Therapeutic confirmatory (Phase III). Countries: Slovakia (ended), Latvia (ended), Hungary (ended), Sweden (ended), Netherlands (ended), Austria (ended), Finland (ended), Germany (ended), Czechia (ended), Norway (ended), Belgium (ended), Spain (ended), Portugal (ended), Italy (ended), France (ended), Denmark (ended), Lithuania (ended), Bulgaria (ended), Poland (ended), Greece (ended).
Therapeutic area(s): Diseases [C] - Cardiovascular Diseases [C14]
Gender: Female, Male. Age: 18-64 years, 65+ years. Enrolment: 5223.
Status: Ended. Start date (EU): 2023-01-18. End date (EU): 2025-10-23. End date: 2025-10-24. Decision date: 2023-09-27. Results received: No. Last updated: 2025-10-29.
Decision dates by country: PL: 2023-10-23, DK: 2023-10-13, BG: 2023-11-01, LT: 2023-10-06, GR: 2023-10-30, BE: 2023-09-28, FI: 2023-09-28, SK: 2023-09-27, LV: 2023-09-27, SE: 2023-09-27, NO: 2023-09-27, NL: 2023-10-02, CZ: 2023-10-02, HU: 2023-09-28, PT: 2023-09-27, IT: 2023-09-29, AT: 2023-10-02, ES: 2023-09-29, DE: 2023-09-29, FR: 2023-10-19

Condition(s): Prevention of ischemic stroke in patients post acute non-cardioembolic ischemic stroke or high-risk transient ischemic attack
Product: BAY 2433334, Placebo for test product BAY 2433334

Primary endpoint: Time to first occurrence of ischemic stroke, Time to first occurrence of ISTH major bleeding
Endpoint(s): Time to first occurrence of all strokes (ischemic and hemorrhagic), Time to first occurrence of composite of Cardiovascular (CV) death, myocardial infarction (MI) or stroke, Time to first occurrence of composite of all-cause mortality, MI or stroke, Time to first occurrence of disabling stroke (mRS >= 3 at 90 days), Time to first occurrence of all-cause mortality, Time to first occurrence of transient ischemic attack (TIA), Time to first occurrence of composite of ISTH major or clinically relevant non-major bleeding, Time to first occurrence of ISTH clinically relevant non-major bleeding, Time to first occurrence of symptomatic intracranial hemorrhage, Time to first occurrence of hemorrhagic stroke, Time to first occurrence of fatal bleeding, Time to first occurrence of minor bleeding, Time to first occurrence of composite of ischemic stroke or ISTH major bleeding, Time to first occurrence of composite of CV death, all stroke, MI or ISTH major bleeding, Time to first occurrence of composite of all-cause mortality, disabling stroke, fatal bleeding, symptomatic intracranial hemorrhage, Time to first occurrence of ischemic stroke in the first 90 days

Source: https://euclinicaltrials.eu/ctis-public/view/2023-503793-20-00